EU clinical trial 2025-522109-39-00: PROlonged Corticosteroid treatment or N-ACetylcysteine for severe alcoholic hepatitis (PROCORNAC)
Protocol code: 2024_0476
Sponsor: Centre Hospitalier Universitaire De Lille (Hospital/Clinic/Other health care facility). Phase: Therapeutic confirmatory (Phase III). Countries: France (ongoing, recruiting).
Therapeutic area(s): Diseases [C] - Digestive System Diseases [C06]
Gender: Female, Male. Age: 18-64 years, 65+ years. Enrolment: 477.
Status: Ongoing, recruiting. Start date (EU): 2026-05-22. Decision date: 2025-10-17. Results received: No. Last updated: 2025-10-17.

Condition(s): Alcoholic hepatitis
Product: SOLUPRED 20 mg, comprimé orodispersible, HIDONAC 5 g/25 ml, solution injectable pour perfusion, Dextrose 5% + Normal saline solutions (10%), Placebo of Prednisolone 10mg, Micronized Prednisolone

Primary endpoint: Rate of patients alive with compensated liver disease defined as a MELD score <17 at 90 days. MELD score will be calculated according to the formula given in Dunn et al. Hepatology 2005: MELD = 9.57 x ln (creatinine in mg/dL) + 3.78 x ln (bilirubin in mg/dL) + 11.2 x ln (INR) + 6.43
Endpoint(s): - Overall survival at 90 and 360 days ; - Rate of patients alive with compensated liver disease defined by a MELD score <17 at 30-days, 60-days,180 and 360 days, Therapeutic response at day 7 assessed by the rate of patients with a Lille score <0.45 as well as the Lille score treated as a continuous variable (assessing the degree of therapeutic response), - Cumulative incidence of infection within the first 90 days; - Cumulative incidence of hepatorenal syndrome within the first 90 days; - Serious adverse events within the first 90 days

Source: https://euclinicaltrials.eu/ctis-public/view/2025-522109-39-00